EU clinical trial 2024-519540-32-00: sElective Serotonin reuPtake inhibitoRs In posT-covid: ESPRIT
Sponsor: Amsterdam UMC Stichting (Patient organisation/association). Phase: Phase III and phase IV (Integrated). Countries: Netherlands (ongoing, recruiting).
Therapeutic area(s): Diseases [C] - Virus Diseases [C02]
Gender: Female, Male. Age: 18-64 years, 65+ years. Enrolment: 160.
Status: Ongoing, recruiting. Start date (EU): 2026-05-06. Decision date: 2025-11-17. Results received: No. Last updated: 2026-04-08.

Condition(s): post COVID
Product: Fluvoxamine 50 mg film-coated tablets, Placebo

Primary endpoint: Fatigue severity (Checklist Individual Strength (CIS-20R) fatigue score) at week 12
Endpoint(s): Fatigue severity (PROMIS fatigue 8), Cognitive functioning (PROMIS) cognitive function 8a, CIS-20R concentration score), Post Exertional Malaise (PEM) (DePaul Symptom Questionnaire (DSQ-PEM), Postural Orthostatic Tachycardia Syndrome (POTS) National Aeronautics and Space Administration (NASA) lean test and DSQ-POTS), Health-related quality of life (HRQL) (PROMIS-29, Bell disability scale)), Side effects, (Antidepressant Side Effect Checklist-21 (ASEC-21) and Frequency, Intensity, Burden of Side Effects Rating scale (FIBSER scale), withdrawal symptoms (Discontinuation- Emergent Signs and Symptoms (DESS) Scale), Biomarkers ((neuro) inflammation makers, glucocorticoid receptor (GR) activity, cortisol, serotonin, IDO-2 -kynurenine pathway (KP) metabolites)., Neuro-imaging substudy: Perfusion (Arterial Spin Labeling MRI), Neuro-imaging substudy: brain functioning and connectivity during resting-state and cognitive effort (challenging N-back (3-back vs. 0-back) with functional Magnetic Resonance Imaging (fMRI), Neuro-imaging substudy: brain metabolites and neuroinflammation (Magnetic Resonance Spectroscopy)

Source: https://euclinicaltrials.eu/ctis-public/view/2024-519540-32-00